EU clinical trial 2025-525113-22-00: A First-in-Human, Open-label, Phase 1 Study to Evaluate Safety, Tolerability, Pharmacokinetics, Pharmacodynamics, and Preliminary Efficacy of NBIM-1008 in Patients with Rheumatoid Arthritis
Protocol code: NBIM-1008-1791
Sponsor: Neurocrine Biosciences Inc. (Pharmaceutical company). Phase: Human Pharmacology (Phase I)- First administration to humans. Countries: Poland (authorised, recruitment pending), Romania (ongoing, recruiting).
Therapeutic area(s): Diseases [C] - Immune System Diseases [C20]
Gender: Female, Male. Age: 18-64 years. Enrolment: 15.
Start date (EU): 2026-06-10. Decision date: 2026-05-29. Results received: No. Last updated: 2026-06-02.
Decision dates by country: RO: 2026-06-02, PL: 2026-05-29

Condition(s): Rheumatoid Arthritis

Source: https://euclinicaltrials.eu/ctis-public/view/2025-525113-22-00